EU clinical trial 2022-502937-24-00: A Phase 3 Randomized, Placebo-Controlled, Double-Blind Study to Evaluate Upadacitinib in Combination with Topical Corticosteroids in Adolescent and Adult Subjects with Moderate to Severe Atopic Dermatitis
Protocol code: M16-047
Sponsor: Abbvie Deutschland GmbH & Co. KG (Pharmaceutical company). Phase: Therapeutic confirmatory (Phase III). Countries: Sweden (ongoing, recruitment ended), Germany (ongoing, recruitment ended), Slovakia (ongoing, recruitment ended), Belgium (ongoing, recruitment ended), Netherlands (ongoing, recruitment ended), France (ongoing, recruitment ended), Austria (ongoing, recruitment ended), Ireland (ongoing, recruitment ended), Italy (ongoing, recruitment ended), Hungary (ongoing, recruitment ended), Norway (ended), Spain (ongoing, recruitment ended), Czechia (ongoing, recruitment ended), Greece (ongoing, recruitment ended), Bulgaria (ongoing, recruitment ended), Croatia (ongoing, recruitment ended), Finland (ongoing, recruitment ended), Portugal (ongoing, recruitment ended).
Therapeutic area(s): Diseases [C] - Immune System Diseases [C20]
Gender: Female, Male. Age: 0-17 years, 18-64 years, 65+ years. Enrolment: 496.
Start date (EU): 2019-01-02. Decision date: 2023-09-20. Results received: No. Last updated: 2026-07-30.
Decision dates by country: NO: 2023-09-25, AT: 2023-10-04, BE: 2023-09-20, CZ: 2023-09-21, FR: 2023-09-25, DE: 2023-09-21, GR: 2023-10-18, HU: 2023-09-21, IE: 2023-09-20, IT: 2023-09-22, ES: 2023-09-22, SE: 2023-09-20, NL: 2023-09-21, SK: 2023-09-20, BG: 2024-10-14, HR: 2024-10-14, FI: 2024-10-07, PT: 2024-09-10

Condition(s): Atopic Dermatitis
Product: FLUOCINOLONE ACETONIDE, Upadacitinib, HYDROCORTISONE, PIMECROLIMUS, TRIAMCINOLONE, Upadacitinib, TACROLIMUS, Placebo for upadacitinib film-coated tablet

Primary endpoint: Proportion of subjects achieving validated IGA scale for Atopic Dermatitis (vIGA-AD) of 0 or 1 with at least two grades of reduction from baseline at Week 16, Proportion of subjects achieving improvement from baseline of at least 75% on Eczema Area Severity Index (EASI 75) at Week 16.
Endpoint(s): Proportion of subjects achieving an improvement (reduction) in Worst Pruritus Numerical Rating Scale (NRS) ≥ 4 from Baseline at Week 16 for subjects with Worst Pruritus NRS ≥ 4 at Baseline, Proportion of subjects achieving a 90% reduction in EASI (EASI 90) at Week 16, Percent change from Baseline of Worst Pruritus NRS at Week 16, Percent change in EASI score from Baseline at Week 16., Proportion of subjects achieving an improvement (reduction) in Worst Pruritus NRS ≥ 4 from Baseline at Week 4 for subjects with Worst Pruritus NRS ≥ 4 at Baseline, Proportion of subjects achieving EASI 75 at Week 4, Proportion of subjects achieving EASI 75 at Week 2, Proportion of subjects achieving EASI 90 at Week 4, Proportion of subjects achieving EASI 100 at Week 16 for 30 mg, Proportion of subjects achieving an improvement (reduction) in Worst Pruritus NRS ≥ 4 from Baseline at Week 1 for subjects with Worst Pruritus NRS ≥ 4 at Baseline.

Source: https://euclinicaltrials.eu/ctis-public/view/2022-502937-24-00